EU clinical trial 2025-524317-88-00: Open-Label Extension Study to Provide Access to ATH434 in Patients with Multiple System Atrophy
Sponsor: Alterity Therapeutics Limited (Pharmaceutical company). Phase: Therapeutic exploratory (Phase II). Countries: France (authorised, recruiting).
Therapeutic area(s): Diseases [C] - Nervous System Diseases [C10]
Gender: Female, Male. Age: 18-64 years, 65+ years. Enrolment: 7.
Status: Authorised, recruiting. Start date (EU): 2026-07-09. Decision date: 2026-05-13. Results received: No. Last updated: 2026-07-08.

Condition(s): Multiple System Atrophy
Product: ATH434-DP2

Primary endpoint: Assessment of long term safety and tolerability based on incidence and severity of AEs and SAEs, changes in laboratory and vital sign parameters including orthostatic measures, exposure to ATH434, treatment discontinuations due to adverse events, and deaths.

Source: https://euclinicaltrials.eu/ctis-public/view/2025-524317-88-00